EU clinical trial 2023-504708-27-00: Cytisine for nicotine-containing electronic cigarette and tobacco cigarette cessation: a randomized placebo-controlled trial
Protocol code: CYT03-2021
Sponsor: University of Rzeszow (Educational Institution). Phase: Therapeutic confirmatory (Phase III). Countries: Poland (ongoing, recruiting).
Therapeutic area(s): Psychiatry and Psychology [F] - Behavior and Behavior Mechanisms [F01]
Gender: Female, Male. Age: 18-64 years, 65+ years. Enrolment: 600.
Status: Ongoing, recruiting. Start date (EU): 2024-11-02. Decision date: 2023-11-03. Results received: No. Last updated: 2026-01-12.
Decision dates by country: PL: 2024-07-08

Condition(s): electronic cigarette cessation
Product: Placebo, which composition is: microcrystalline cellulose, magnesium stearate, and a forcoat green coating, CYTISINE

Primary endpoint: Biochemically verified (negative urine cotinine and NNAL concentration) continuous EC containing nicotine and TC abstinence for 26 weeks preceding the 30-week follow-up (from 4 week to 30 week) post the start of treatment., Continuous EC containing nicotine cessation will be defined as self-reporting having remained quit for 26 weeks preceding follow-up at 30-week from the start of treatment and, allowing for no more than 5 vaping occasions, whether it be one puff or many while still holding the device (when the device is put away or after 10 min. the occasion is over, whichever comes first), with the additional criterion of no slip-ups (not even a puff) in the last week, and return of a negative biochemical test (cotinine and NNAL)., Continuous TC cessation will be defined as self-reporting having remained quit for 26 weeks preceding follow-up at 30-week from the start of treatment (having smoked no more than five cigarettes in that time, i.e,. Russell standard) and return of a negative biochemical test., Only participants self-reporting continuous abstinence at final follow-up will be biochemically verified., A participant with urine concentration < 50 ng/mL and urine NNAL concentration < 10 pg/ml will be considered abstinent from EC containing nicotine and TC., A participant who vapes EC not containing nicotine (0 mg/mL) will be considered abstinent., Participants who will report abstinence but will be unable or unwilling to complete biochemical verification (urine cotinine) will be classified as using EC (treatment failure) for the primary outcome., . Participants who will report abstinence but will be unable or unwilling to complete biochemical verification (urine cotinine and NNAL) will be classified as using EC and TC (treatment failure) for the primary outcome.
Endpoint(s): Self-reported continuous EC containing nicotine abstinence defined as self-report of having vaped no EC containing nicotine allowing for no more than 5 vaping occasions, whether it be one puff or many while still holding the device (when the device is put away or after 10 min the occasion is over, whichever comes first), with the additional criterion of no slip-ups, not even a puff, in the last week for 26 weeks preceding follow-up at 30- week (from 4 week to 30 week) post the start of treatment, Self-reported continuous EC containing nicotine abstinence at 2-week, 4-week, and 12- week post the start of treatment, Self-reported continuous TC abstinence defined as self-report of having remained quit for 26 weeks preceding follow-up at 30-week from the start of treatment (having smoked no more than five cigarettes in that time, i.e., Russell standard), Self-reported continuous TC abstinence at 2-week, 4-week, and 12-week post the start of treatment, Self-reported 7-day point prevalence abstinence defined as prevalence of abstinence (no TC, not a single vaping EC containing nicotine) during seven consecutive days immediately preceding 2-week, 4-week, 12-week, and 30-week interview, Biochemically verified (negative urine cotinine and NNAL concentration) 7-day point prevalence abstinence defined as prevalence of abstinence (no TC, not a single vaping EC containing nicotine) during seven consecutive days immediately preceding 30-week interview, Self-reported nicotine consumption from EC per day and week (strength and volume of eliquid/cartridge used per day) at 2-week, 4-week, 12-week, and 30-week post the start of treatment among those participants who continue EC using, The proportion of SAEs and AEs compared across cytisine and placebo groups

Source: https://euclinicaltrials.eu/ctis-public/view/2023-504708-27-00